EU clinical trial 2024-514826-22-00: A multicenter phase 1/2 dose-finding and dose expansion study of OSE-279, a PD-1 blocking monoclonal antibody, in subjects with advanced solid tumors or lymphomas
Protocol code: OSE-279-C101
Sponsor: OSE Immunotherapeutics (Pharmaceutical company). Phase: Phase I and Phase II (Integrated)- First administration to humans. Countries: France (ongoing, recruiting), Belgium (ongoing, recruiting), Spain (ongoing, recruiting).
Therapeutic area(s): Diseases [C] - Neoplasms [C04]
Gender: Female, Male. Age: 18-64 years, 65+ years. Enrolment: 70.
Status: Ongoing, recruiting. Start date (EU): 2022-12-05. Decision date: 2024-11-06. Results received: No. Last updated: 2025-09-25.
Decision dates by country: BE: 2024-11-06, ES: 2025-04-15, FR: 2024-11-07

Condition(s): Part A: Patients with advanced solid tumors or lymphomas., Part B and C: Patients with HLA-A2 positive phenotype and metastatic Non Small Cell Lung Cancer.
Product: OSE-279, TEDOPI

Primary endpoint: Part A: Occurrence of dose limiting toxicity (DLT) for MTD determination and/or RP2D., Part B: Occurrence of dose limiting toxicity (DLT) where DLT observation period is defined as the first 6 weeks after receiving the first injections of OSE-279 and of OSE2101., Part C: ORR: Complete Response (CR) and Partial Response (PR) rate.
Endpoint(s): Part A: Efficacy (Objective Response Rate (ORR): Complete Response (CR) and Partial Response (PR) rate ; Disease Control Rate (DCR): CR, PR and Stable Disease (SD) rate; • Time to response (TTR); • Duration of Objective Response (DOR); Progression Free Survival (PFS); DCR (CR+PR+SD) at 12 weeks; Overall Survival (OS))., Part A: Pharmacokinetics and Pharmacodynamics (OSE-279 Pharmacokinetic parameters; Detection of anti-OSE-279 antibodies)., Part B: Efficacy (ORR: Complete Response (CR) and Partial Response (PR) rate; DCR: CR, PR and Stable Disease (SD) rate; Time to response (TTR); Duration of Objective Response (DOR); • Progression Free Survival (PFS); DCR (CR+PR+SD) at 12 weeks and 24 weeks; Overall Survival (OS); OS rate at 12 months)., Part B: Safety (Nature, incidence and severity of TEAE (including DLT and AE of special Interest (AESI)), of SAE, SUSARs graded according to CTCAE grading v5.0)., Part C: Efficacy (DCR: CR, PR and Stable Disease (SD) rate; Time to response (TTR); Duration of Objective Response (DOR); • Progression Free Survival (PFS); DCR (CR+PR+SD) at 12 weeks and 24 weeks; Overall Survival (OS); OS rate at 12 months)., Part C: Safety (Nature, incidence and severity of TEAE (including DLT like events and AESI), of SAE, SUSARs graded according to CTCAE grading version 5.0).

Source: https://euclinicaltrials.eu/ctis-public/view/2024-514826-22-00